EU clinical trial 2024-518728-59-00: Multicenter, open-label, randomized, 2-arm, phase II study to evaluate the efficacy and safety of cetuximab plus irinotecan rechallenge compared with investigator's choice of therapy in the third-line setting in ctDNA genomically selected patients with metastatic colorectal cancer (CITRIC Study)
Sponsor: Associacio Per A La Recerca Oncologica (Laboratory/Research/Testing facility). Phase: Therapeutic exploratory (Phase II). Countries: Spain (ended).
Therapeutic area(s): Diseases [C] - Neoplasms [C04]
Gender: Female, Male. Age: 18-64 years, 65+ years. Enrolment: 58.
Status: Ended. Start date (EU): 2020-10-23. End date (EU): 2025-06-19. Decision date: 2024-10-25. Results received: Yes. Last updated: 2024-10-25.

Condition(s): metastatic colorectal cancer
Product: IRINOTECAN, CETUXIMAB

Primary endpoint: The primary endpoint of the study is the ORR, defined as the percentage of patients achieving a CR or PR as the best overall response, according to Response Evaluation Criteria in Solid Tumors (RECIST) version 1.1 (Eisenhauer 2009) from randomization to disease progression, death, or premature withdrawal from study treatment due to any reason, including unacceptable toxicity, whichever is first, in both study arms.
Endpoint(s): DCR, defined as the percentage of patients achieving CR, PR or SD, as the best overall response according to RECIST v1.1, from randomization to disease progression, death, or premature withdrawal from study treatment, whichever is first, in both study arms., DDC, defined as the time elapsed from first CR, PR or SD to first observed progression or death from any cause, among patients achieving CR, PR or SD, in both study arms., TTF, defined as the time elapsed from randomization to the end date of study treatment for any reason (including but not limited to disease progression or unacceptable toxicity) or date of progressive disease, whichever occurs first, in both study arms., PFS, defined as the time elapsed from randomization to the date of first observed progression or death due to any cause, whichever is first, in both study arms., OS, defined as the time elapsed from randomization to the date of death due to any cause, in both study arms., The safety profile of cetuximab plus irinotecan treatment and of the investigator´s choice of treatment in the third-line setting will be measured based on all AEs (serious and nonserious) experienced since randomization, classified and graded according to NCICTCAE version 5.0 (Cho 2019), and any abnormal findings on physical examination, vital signs, laboratory results, electrocardiogram (ECG) and imaging tests through the study., Emergence/expression level of additional potential biomarker related to treatment resistance including but not limited to MAPKs pathway mutations, alternative receptor activation, PIK3CA mutations (ctDNA), as well as immunologic characteristics in peripheral blood and tumor tissue (primary tumor or metastases) during the screening period (before treatment initiation), at week 8 after randomization and at the end-of-treatment visit in both study arms.

Source: https://euclinicaltrials.eu/ctis-public/view/2024-518728-59-00